EU clinical trial 2024-511581-37-00: A Randomised, Placebo-Controlled, 3-Arm, Double-Blind, Multicentre, Phase 4 Study to Assess the Efficacy of OM-85 (Broncho Vaxom) Short- and Long-Term Treatment vs. Placebo in the Prevention of Respiratory Tract Infections in Children Aged Between 6 Months and 5 Years with Wheezing Lower Respiratory Illness
Protocol code: BV-2020/08
Sponsor: OM Pharma SA (Pharmaceutical company). Phase: Therapeutic use (Phase IV). Countries: Hungary (ended), Germany (ongoing, recruitment ended), Poland (ongoing, recruitment ended), Italy (ended).
Therapeutic area(s): Diseases [C] - Respiratory Tract Diseases [C08]
Gender: Female, Male. Age: 0-17 years. Enrolment: 497.
Start date (EU): 2022-11-25. Decision date: 2024-06-11. Results received: No. Last updated: 2026-07-20.
Decision dates by country: IT: 2024-07-01, PL: 2024-07-01, HU: 2024-06-11, DE: 2024-06-13

Condition(s): Respiratory Tract Infections with Wheezing Lower Respiratory Illness
Product: Placebo to BRONCHO-VAXOM, BRONCHO-VAXOM® Kinder, 3,5 mg, Kapseln

Primary endpoint: Primary efficacy endpoint is the rate of RTIs during the 12-month Treatment period, defined as the number of RTIs experienced by a subject during the Treatment period.
Endpoint(s): Rate of wLRIs during the 12-month Treatment period, defined as number of wLRIs experienced by a subject during the Treatment period.

Source: https://euclinicaltrials.eu/ctis-public/view/2024-511581-37-00